EU clinical trial 2023-506872-29-00: A Multicenter, Long-term Extension Study to Evaluate the Safety, Tolerability, and Efficacy of AL002 in Participants with Alzheimer's Disease
Protocol code: AL002-LTE
Sponsor: Alector LLC (Pharmaceutical company). Phase: Therapeutic exploratory (Phase II). Countries: Germany (ended), Netherlands (ended), Spain (ended), Poland (ended), Italy (ended), France (ended).
Therapeutic area(s): Diseases [C] - Nervous System Diseases [C10]
Gender: Female, Male. Age: 18-64 years, 65+ years. Enrolment: 178.
Status: Ended. Start date (EU): 2023-04-13. End date (EU): 2024-11-25. End date: 2025-01-31. Decision date: 2023-11-30. Results received: Yes. Last updated: 2025-01-22.
Decision dates by country: IT: 2023-12-11, DE: 2023-12-01, PL: 2023-12-14, NL: 2023-11-30, FR: 2025-01-22, ES: 2023-11-30

Condition(s): Alzheimer's Disease
Product: florquinitau F18, Placebo: sterile solution for intravenous infusion, Human ICG1 Monoclonal Antibody Against Trem2

Primary endpoint: Incidence of AEs, including AESIs and SAEs, Vital signs, clinical laboratory results, and incidence of findings from physical, neurological, ophthalmological examinations, and ECG, C-SSRS, MRI abnormalities, Incidence and severity of ARIA in participants undergoing titration

Source: https://euclinicaltrials.eu/ctis-public/view/2023-506872-29-00